EU clinical trial 2024-520142-32-00: A study investigating the safety, absorption, and elimination of NT 0150, a new compound that may potentially be used in the treatment of brain disorders, like Alzheimer’s disease and Parkinson’s disease.
Protocol code: NT-0150-P001
Sponsor: Nodthera Limited (Pharmaceutical company). Phase: Human Pharmacology (Phase I)- First administration to humans. Countries: Netherlands (ended).
Therapeutic area(s): Diseases [C] - Immune System Diseases [C20]
Gender: Female, Male. Age: 18-64 years, 65+ years. Enrolment: 53.
Status: Ended. Start date (EU): 2025-09-08. End date (EU): 2026-06-08. Decision date: 2025-09-05. Results received: No. Last updated: 2025-09-05.

Condition(s): Cryopyrin associated periodic syndrome

Source: https://euclinicaltrials.eu/ctis-public/view/2024-520142-32-00